EU clinical trial 2023-510150-17-00: A Phase 2, open-label study to evaluate the efficacy and safety of rapcabtagene autoleucel in patients with active, refractory systemic lupus erythematosus (SLE), or active, refractory lupus nephritis (LN).
Protocol code: CYTB323J12201
Sponsor: Novartis Pharma AG (Pharmaceutical company). Phase: Therapeutic exploratory (Phase II). Countries: France (ongoing, recruiting), Spain (ongoing, recruiting), Italy (ongoing, recruiting), Netherlands (ongoing, recruiting), Germany (ongoing, recruiting), Czechia (ongoing, recruiting), Austria (ongoing, recruiting), Romania (ongoing, recruiting), Hungary (ongoing, recruiting), Denmark (ongoing, recruiting), Sweden (ongoing, recruiting), Norway (ongoing, recruiting), Poland (authorised, recruitment pending).
Therapeutic area(s): Diseases [C] - Immune System Diseases [C20]
Gender: Female, Male. Age: 18-64 years, 65+ years. Enrolment: 93.
Start date (EU): 2024-12-11. Decision date: 2024-09-30. Results received: No. Last updated: 2026-05-18.
Decision dates by country: NO: 2025-02-27, RO: 2025-02-03, IT: 2024-10-02, SE: 2025-02-20, FR: 2024-09-30, NL: 2024-10-04, DE: 2024-10-04, CZ: 2025-02-26, DK: 2025-02-10, HU: 2025-03-10, PL: 2026-05-11, ES: 2024-10-03, AT: 2025-03-03

Condition(s): Active, refractory systemic lupus erythematosus (SLE), and active, refractory lupus nephritis (LN)
Product: RITUXIMAB, MYCOPHENOLATE MOFETIL, YTB323, FLUDARABINE PHOSPHATE, VOCLOSPORIN, TACROLIMUS, RITUXIMAB, MYCOPHENOLIC ACID, CYCLOPHOSPHAMIDE, TOCILIZUMAB, CYCLOPHOSPHAMIDE, AZATHIOPRINE, BELIMUMAB

Primary endpoint: Complete renal response (CRR) at Week 52., Achieving DORIS defined as meeting the criteria of the Definition Of Remission In Systemic Lupus Erythematosus (DORIS) at Week 52 defined as in Section 8.3.1, DORIS is defined as meeting the criteria of the Definition Of Remission In Systemic Lupus Erythematosus (DORIS): • Clinical SLEDAI-2K of 0 at the respective timepoint AND • Achieving a Physician Global Assessment (PhGA) score of < 0.5 at that timepoint AND • Stable immunomodulatory/immunosuppressive treatment
Endpoint(s): DORIS at Week 52, Number of weeks where Lupus Low Disease Activity Score (LLDAS) was achieved until Week 52, Absence of flaring (i.e., 1 new BILAG2004 A or 2 new BILAG2004 B flares) through Week 52, Annualized cumulative corticosteroids dose until Week 52, Negative serological status at Week 52, FACIT-Fatigue score change from baseline to Week 52, Achieving DORIS at Week 52 and continuing to remain in remission as per the DORIS criteria., Safety parameters including vital signs, adverse events, laboratory parameters and ECG evaluation, Complete renal response (CRR) at Week 52

Source: https://euclinicaltrials.eu/ctis-public/view/2023-510150-17-00